EU clinical trial 2024-520322-11-00: A Randomized, Double-Blind, Placebo- and Open-Label Active Comparator- Controlled, Parallel-Group, Multi-Center Phase II Study to Evaluate the Efficacy, Safety, and Tolerability of Once-Daily RO7795081 Administered for 30 Weeks to Participants with Type 2 Diabetes Mellitus
Protocol code: BP45703
Sponsor: F. Hoffmann-La Roche AG (Pharmaceutical company). Phase: Therapeutic exploratory (Phase II). Countries: Poland (ongoing, recruitment ended), Spain (ongoing, recruitment ended), Hungary (ongoing, recruitment ended).
Therapeutic area(s): Diseases [C] - Nutritional and Metabolic Diseases [C18]
Gender: Female, Male. Age: 18-64 years, 65+ years. Enrolment: 74.
Status: Ongoing, recruitment ended. Start date (EU): 2025-09-29. Decision date: 2025-09-05. Results received: No. Last updated: 2026-06-16.
Decision dates by country: HU: 2025-09-05, ES: 2025-09-08, PL: 2025-09-08

Condition(s): Type 2 Diabetes Mellitus (T2D)
Product: RO7795081, RO7795081, Rybelsus 3 mg tablets, Rybelsus 7 mg tablets, Rybelsus 14 mg tablets, Rybelsus 9 mg tablets, Rybelsus 1.5 mg tablets, Rybelsus 4 mg tablets, oral GLP-1R agonist (CT-996) Capsule, hard 0 mg / 1 EA - F10, RO7795081

Primary endpoint: Change in HbA1c from baseline at Week 30
Endpoint(s): Change in HbA1c from baseline at Week 30, Percentage of participants with HbA1c < 5.7%, ≤ 6.5%, and < 7.0% at Week 30, Change in fasting plasma glucose from baseline at Week 30, Percent (%) change in body weight from baseline at Week 30, Absolute change in body weight (kg) from baseline at Week 30, Percentage of participants who achieve ≥ 5%, ≥ 10%, or ≥ 15% body weight reduction at Week 30, Incidence of AEs, AESIs, and SAEs, Number of participants with documented hypoglycemia (Level 1, 2, or 3 per ADA 2024), Change in safety laboratory values and vital signs, Change in ECG parameters, Plasma concentrations of RO7795081

Source: https://euclinicaltrials.eu/ctis-public/view/2024-520322-11-00